EU clinical trial 2022-503107-21-00: A Study to Evaluate the Safety, Pharmacokinetics, and Activity of Belvarafenib as a Single Agent and in Combination with Either Cobimetinib or Cobimetinib Plus Nivolumab in Patients with NRAS-Mutant Advanced Melanoma
Protocol code: GO42273
Sponsor: Genentech Inc. (Pharmaceutical company). Phase: Human Pharmacology (Phase I)- Other. Countries: Germany (ended), Norway (ended).
Therapeutic area(s): Diseases [C] - Neoplasms [C04]
Gender: Female, Male. Age: 18-64 years, 65+ years. Enrolment: 15.
Status: Ended. Start date (EU): 2021-05-14. End date (EU): 2025-09-04. Decision date: 2023-11-30. Results received: No. Last updated: 2025-08-22.
Decision dates by country: DE: 2023-11-30, NO: 2023-11-30

Condition(s): NRAS-mutant advanced cutaneous melanoma

Source: https://euclinicaltrials.eu/ctis-public/view/2022-503107-21-00